EU clinical trial 2023-505035-12-00: A Phase III, Randomized, Open-Label Study of Pralsetinib versus Standard Of Care for First-Line Treatment of RET Fusion-Positive, Metastatic Non-Small Cell Lung Cancer
Protocol code: BO42864
Sponsor: F. Hoffmann-La Roche AG (Pharmaceutical company). Phase: Therapeutic confirmatory (Phase III). Countries: France (ended), Netherlands (ended), Belgium (ended), Germany (ended), Spain (ended), Portugal (ended), Poland (ended), Norway (ended), Italy (ended), Ireland (ended).
Therapeutic area(s): Diseases [C] - Neoplasms [C04]
Gender: Female, Male. Age: 18-64 years, 65+ years. Enrolment: 140.
Status: Ended. Start date (EU): 2020-06-12. End date (EU): 2025-01-27. End date: 2025-01-28. Decision date: 2024-04-05. Results received: Yes. Last updated: 2025-03-03.
Decision dates by country: DE: 2024-04-10, BE: 2024-04-08, IE: 2024-04-05, IT: 2024-04-09, PL: 2024-04-15, ES: 2024-04-08, NL: 2024-04-08, FR: 2024-04-15, NO: 2024-04-08, PT: 2024-04-08

Condition(s): RET fusion−positive, metastatic Non-Small Cell Lung Cancer
Product: CARBOPLATIN, GEMCITABINE, PEMETREXED, Sindaxel 6 mg/ml concentrat pentru soluţie perfuzabilă, KEYTRUDA 25 mg/mL concentrate for solution for infusion, CISPLATIN, Abraxane 5 mg/ml powder for dispersion for infusion., RO 749-9790/F02-02

Primary endpoint: 1. PFS, defined as the time from randomization date to the first of documented progressive disease (PD), as assessed by investigator according to Response Evaluation Criteria in Solid Tumors version 1.1 (RECIST v1.1) or death due to any cause, whichever occurs first
Endpoint(s): 1. Objective response rate (ORR) defined as the proportion of participants with a CR or a PR on two consecutive occasions ≥ 4 weeks apart, as assessed by investigator according to RECIST v1.1, 2. Overall survival (OS), defined as the time to randomization date to death due to any cause., 3. Incidence and severity of adverse events, with severity, as determined according to the National Cancer Institute Common Toxicity Criteria for Adverse Events version 5.0, 4. Change from baseline in ECOG performance status, 5. Change from baseline in targeted vital signs, 6. Change from baseline in targeted clinical laboratory test results, 7. Duration of response (DOR), defined as the time from the first occurrence of a documented objective response to disease progression or death from any cause (whichever occurs first), as assessed by investigator according to RECIST v1.1, 8. Disease control rate (DCR), defined as the proportion of participants who experience a best response of CR, or PR, or SD, as assessed by investigator according to RECIST v1.1, 9. Clinical benefit rate (CBR), defined as the proportion of participants who experience a best response of SD with a minimum duration of 6 months, a CR, or a PR, as assessed by investigator according to RECIST v1.1

Source: https://euclinicaltrials.eu/ctis-public/view/2023-505035-12-00